EU clinical trial 2023-508612-29-00: A Randomized, Controlled, Multicenter, Phase 3 Clinical Study Comparing Vusolimogene Oderparepvec in Combination with Nivolumab Versus Treatment of Physician’s Choice in Patients with Advanced Melanoma That Has Progressed on an Anti-PD-1 and an Anti-CTLA-4 Containing Treatment Regimen [IGNYTE-3]
Protocol code: RP1-104
Sponsor: Replimune Inc. (Pharmaceutical company). Phase: Therapeutic confirmatory (Phase III). Countries: Greece (ongoing, recruiting), Spain (ongoing, recruiting), Poland (ongoing, recruiting), France (ongoing, recruiting), Italy (authorised, recruitment pending), Germany (ongoing, recruiting).
Therapeutic area(s): Diseases [C] - Neoplasms [C04]
Gender: Female, Male. Age: 0-17 years, 18-64 years, 65+ years. Enrolment: 193.
Start date (EU): 2025-11-07. Decision date: 2025-07-15. Results received: No. Last updated: 2026-07-24.
Decision dates by country: FR: 2025-07-16, DE: 2025-07-25, IT: 2025-07-16, PL: 2025-07-18, GR: 2025-07-15, ES: 2025-08-05

Condition(s): Advanced Melanoma
Product: TEMOZOLOMIDE VIATRIS 5 mg, gélule, Vusolimogene oderparepvec, OPDIVO 10 mg/mL concentrate for solution for infusion., Dacarbazine medac 100 mg, powder for solution for injection/infusion, Opdualag 240 mg/80 mg concentrate for solution for infusion, KEYTRUDA 25 mg/mL concentrate for solution for infusion, Vusolimogene oderparepvec, Paclitaxel 6mg/ml Concentrate for Solution for Infusion

Primary endpoint: Overall survival (OS)
Endpoint(s): Progression-free survival (PFS) (as per Response Evaluation Criteria in Solid Tumors, version 1.1 [RECIST 1.1]), ORR (as per RECIST 1.1), Complete response rate (CRR), Duration of response (DOR), Disease control rate (DCR), PFS at 1 and 2 years, Survival rates at 1, 2 and 3 years, Frequency, nature, and severity of treatment-emergent adverse events (TEAEs), including serious adverse events

Source: https://euclinicaltrials.eu/ctis-public/view/2023-508612-29-00